EU clinical trial 2023-508000-37-01: GLYCOGEN RESPONSE TO ENZYME REPLACEMENT THERAPY IN POMPE DISEASE
Sponsor: Rigshospitalet (Hospital/Clinic/Other health care facility). Phase: Therapeutic use (Phase IV). Countries: Denmark (ongoing, recruiting).
Therapeutic area(s): Diseases [C] - Nutritional and Metabolic Diseases [C18]; Diseases [C] - Musculoskeletal Diseases [C05]; Diseases [C] - Congenital, Hereditary, and Neonatal Diseases and Abnormalities [C16]
Gender: Female, Male. Age: 18-64 years, 65+ years. Enrolment: 10.
Status: Ongoing, recruiting. Start date (EU): 2024-02-13. Decision date: 2024-01-16. Results received: No. Last updated: 2025-08-22.

Condition(s): Pompe Disease
Product: Nexviadyme 100 mg powder for concentrate for solution for infusion

Primary endpoint: Change in glycogen concentration of the hamstring muscles between baseline and 12-month follow-up
Endpoint(s): Change in glycogen concentration of the calf, hamstring, anterior thigh, and lumbar muscles over time – both within the first treatment cycle, and at 3, 6 and 12-months follow-up, Change in fat-fraction of the calf, hamstring, anterior thigh, and lumbar muscles from baseline to 3, 6 and 12-months follow-up., Correlations between baseline glycogen levels and change in FVC between baseline and 12-months follow-up., Correlations between baseline glycogen levels and change in 6MWT between baseline and 12-months follow-up., Correlations between baseline glycogen levels and change in fat-fraction of the calf, hamstring, anterior thigh, and lumbar muscles from baseline to 12-months follow-up.

Source: https://euclinicaltrials.eu/ctis-public/view/2023-508000-37-01